EU clinical trial 2023-505858-18-00: A study of PF-08046050 (SGN-CEACAM5C) in adults with advanced solid tumors
Protocol code: C5831001
Sponsor: Seagen Inc. (Pharmaceutical company). Phase: Human Pharmacology (Phase I)- First administration to humans. Countries: France (temporarily halted), Netherlands (temporarily halted), Spain (temporarily halted), Sweden (temporarily halted).
Therapeutic area(s): Diseases [C] - Neoplasms [C04]
Gender: Female, Male. Age: 18-64 years, 65+ years. Enrolment: 175.
Status: Temporarily halted. Start date (EU): 2024-06-28. Decision date: 2024-05-30. Results received: No. Last updated: 2026-03-30.
Decision dates by country: ES: 2024-05-30, NL: 2024-06-03, FR: 2024-06-03, SE: 2024-05-31

Condition(s): Pancreatic carcinoma, Non-small cell lung cancer – nonsquamous, Non-small cell lung cancer – squamous, Small cell lung cancer, Gastroesophageal junction adenocarcinoma, Gastric cancer, Colorectal cancer

Source: https://euclinicaltrials.eu/ctis-public/view/2023-505858-18-00